EU clinical trial 2024-518838-82-00: Hippocrates; The use of FAPI-PET/CT and FDG-PET/CT scan in acute and chronic phase Peyronie’s disease for detection of active fibroblasts and inflammation in the penis - a pilot study
Protocol code: Hippocrates
Sponsor: Universitair Medisch Centrum Groningen (Hospital/Clinic/Other health care facility). Phase: Therapeutic use (Phase IV). Countries: Netherlands (ongoing, recruiting).
Therapeutic area(s): Diseases [C] - Male Urogenital Diseases [C12]; Analytical, Diagnostic and Therapeutic Techniques and Equipment [E] - Diagnosis [E01]
Gender: Male. Age: 18-64 years, 65+ years. Enrolment: 20.
Status: Ongoing, recruiting. Start date (EU): 2024-12-13. Decision date: 2024-12-05. Results received: No. Last updated: 2026-07-06.

Condition(s): Peyronie's Disease
Product: [68Ga]FAPI-46

Primary endpoint: Detection of active fibroblasts or inflammation in the penis of new onset PD patients with FAPI-PET/CT scan and/or FDG-PET/CT scan.
Endpoint(s): To distinguish visual uptake of FDG-PET/CT scan and FAPI-PET/CT scan between active phase PD and chronic phase PD

Source: https://euclinicaltrials.eu/ctis-public/view/2024-518838-82-00